EU clinical trial 2024-518294-34-01: Efficacy and Safety of BT200 (rondaptivon pegol) in Patients with Type 2B von Willebrand disease
Protocol code: BT200-VWD2B
Sponsor: Medical University Of Vienna (Educational Institution). Phase: Therapeutic exploratory (Phase II). Countries: Austria (ongoing, recruiting).
Therapeutic area(s): Diseases [C] - Hemic and Lymphatic Diseases [C15]
Gender: Female, Male. Age: 18-64 years, 65+ years. Enrolment: 6.
Status: Ongoing, recruiting. Start date (EU): 2023-07-21. Decision date: 2024-12-09. Results received: No. Last updated: 2024-12-09.

Condition(s): Von Willebrand's Disease Type 2B
Product: 0.9% sodium chloride solution, Rondaptivon pegol

Primary endpoint: Co-Primary endpoints: Platelet counts, number of monthly bleedings events
Endpoint(s): Pharmacokinetics: • BT200 concentrations (and derived PK parameters) • Half-life of the substituted Factor VIII product used with and without BT200 (pop-PK-sub-study), Pharmacodynamics: • VWF antigen (VWF Ag) • VWF:ristocetin co-factor assay (VWF:RCo) • VWF activity (VWF:GpIbM assay) • VWF collagen binding assay (VWF:CBA) • Enzyme-linked immunosorbent assay (ELISA) for unbound VWF A1 domain (REAADS®) • Whole blood ristocetin induced platelet aggregation (Multiplate®) • Collagen Adenosine Diphosphate closure times measured by the platelet function analyser (PFA-100®)

Source: https://euclinicaltrials.eu/ctis-public/view/2024-518294-34-01